EU clinical trial 2022-502798-40-00: A Phase III double-blind placebo-controlled Randomised Trial of Aspirin on Recurrence and Survival in Colon Cancer Patients.
Protocol code: BE 2017-001397-41
Sponsor: Antwerp University Hospital (Hospital/Clinic/Other health care facility). Phase: Therapeutic confirmatory (Phase III). Countries: Belgium (ongoing, recruitment ended).
Therapeutic area(s): Diseases [C] - Neoplasms [C04]
Gender: Female, Male. Age: 18-64 years, 65+ years. Enrolment: 400.
Status: Ongoing, recruitment ended. Start date (EU): 2017-07-31. Decision date: 2023-03-14. Results received: No. Last updated: 2026-07-29.

Condition(s): Patients with resected colon carcinoma
Product: PLACEBO, ACETYLSALICYLIC ACID

Primary endpoint: The primary endpoint is 5 year Overall Survival (5y-OS). The time to an event for OS is defined as the time interval between the date of randomisation and the date of death. A patient that is still alive at the last date of follow-up patient is censored for analysis and the time at risk corresponds to the time interval between the date of randomisation and the date of last follow up.
Endpoint(s): Disease Free Survival (DFS). The time to an event for DFS is defined as the time interval between the date of randomisation and the date of disease recurrence or death, whichever comes first. Recurrence of a disease can be a loco-regional recurrence, a distant recurrence or a new primary colon cancer. The evidence for recurrence must be documented in the patients’ file. The date of radiological evidence, e.g. CT, MRI, etc, or colonoscopy will be considered as date of recurrence., Time to Treatment Failure (TTF). The time elapsed between randomisation until treatment discontinuation due to disease progression, unacceptable toxicity, death or any other event of interest.

Source: https://euclinicaltrials.eu/ctis-public/view/2022-502798-40-00